EU clinical trial 2024-515295-12-00: Adjuvant dendritic cell immunotherapy complementing conventional therapy for pediatric patients with high-grade glioma and diffuse intrinsic pontine glioma
Protocol code: ADDICT-pedGLIO
Sponsor: Antwerp University Hospital (Hospital/Clinic/Other health care facility). Phase: Therapeutic exploratory (Phase II). Countries: Belgium (ended).
Therapeutic area(s): Diseases [C] - Nervous System Diseases [C10]; Analytical, Diagnostic and Therapeutic Techniques and Equipment [E] - Therapeutics [E02]; Diseases [C] - Neoplasms [C04]; Phenomena and Processes [G] - Immune system processes [G12]
Gender: Female, Male. Age: 0-17 years. Enrolment: 10.
Status: Ended. Start date (EU): 2021-10-06. End date (EU): 2025-08-31. Decision date: 2024-11-04. Results received: No. Last updated: 2025-01-20.
Decision dates by country: BE: 2024-12-16

Condition(s): High-grade glioma (HGG), Diffuse intrinsic pontine glioma (DIPG)
Product: WT1 LAMP mRNA DC

Primary endpoint: Feasibility, based on the proportion of (A) patients in the intention-to-treat (ITT) population that had successful leukapheresis, (B) patients in the ITT population that had successful vaccine production (i.e. production of 9 or more vaccines meeting quality control requirements), (C) patients in the ITT population who complete the study treatment schedule (i.e. from leukapheresis until administration of the 9th vaccine), (D) efficacy evaluable patients in the ITT population, Safety: Occurrence of AEs and SAEs during DC vaccine administration and follow-up period (A) Proportion of patients of the safety population that experienced (S)AEs possibly, probably or definitely related to DC vaccination, (B) Number and grade of (S)AEs in the safety population
Endpoint(s): Indicators of clinical activity: (A) Best overall response, (B) Progression free survival, (C) Overall survival, Immunogenicity, including, but not limited to, the following measures of (anti-tumor) immune responses: (A) Functional WT1-specific T cell responses, (B) Occurrence of WT1-specific CD8+ T cells, (C) Functional WT1-specific T cell responses, Quality of life: (A) How patients experience different phases of the study treatment schedule, (B) How patient- and proxy-reported disease-related symptoms evolve over time during the study, (C) How patient- and proxy-reported general quality of life evolves over time during the study

Source: https://euclinicaltrials.eu/ctis-public/view/2024-515295-12-00